EU clinical trial 2023-509204-15-00: Bevacizumab plus encorafenib-cetuximab in BRAF-V600E mutated metastatic colorectal cancer, a phase II study with a safety lead-in cohort, the BRAVE trial
Protocol code: VHIO23001
Sponsor: Vall D Hebron Institute Of Oncology (Laboratory/Research/Testing facility). Phase: Therapeutic exploratory (Phase II). Countries: Spain (ongoing, recruiting).
Therapeutic area(s): Diseases [C] - Neoplasms [C04]
Gender: Female, Male. Age: 18-64 years, 65+ years. Enrolment: 94.
Status: Ongoing, recruiting. Start date (EU): 2024-05-17. Decision date: 2024-02-08. Results received: No. Last updated: 2026-06-19.

Condition(s): Metastatic colorectal cancer
Product: Erbitux 5 mg/mL solution for infusion, MVASI 25 mg/mL concentrate for solution for infusion, Braftovi 75 mg hard capsules, MVASI 25 mg/mL concentrate for solution for infusion

Primary endpoint: • Progression free survival (PFS) by local radiologist/investigator assessment per Response Evaluation Criteria in Solid Tumors (RECIST), version 1.1 (v1.1). For the safety lead-in phase only: • Incidence of dose-limiting toxicity (DLTs) during 1 month.
Endpoint(s): • Incidence and severity of AEs graded according to the NCI CTCAE v5.0 and changes in clinical laboratory parameters, vital signs and ECGs during the treatment until 30+/-2 days after EOT. • Incidence of dose delays, dose modifications and discontinuations due to AEs., • Overall Response Rate (ORR) per RECIST v1.1, defined as the number of patients achieving an overall best response of complete response (CR) or partial response (PR) divided by the total number of patients. • Time to response, defined as the time from first dose to first radiographic evidence of response. • Duration of Response (DOR), defined as the time from first radiographic evidence of response to the earliest documented disease progression or death due to underlying disease., • Overall Survival (OS), defined as the time from first dose to death due to any cause., • Change in PRO as measured by the European Organization for Research and Treatment of Cancer (EORTC) Quality of Life Questionnaire for Cancer Patients (QLQ-C30) and Functional Assessment of Cancer Therapy-Colon Cancer (FACT-C).

Source: https://euclinicaltrials.eu/ctis-public/view/2023-509204-15-00